EU clinical trial 2025-520751-83-00: Long-term clinical trial on tolerability, toxicity, pharmacokinetics and molecular mechanisms of action of EPI-EE
Sponsor: Hospital General De Tomelloso (Hospital/Clinic/Other health care facility). Phase: Human Pharmacology (Phase I)- Other. Countries: Spain (authorised, recruitment pending).
Therapeutic area(s): Phenomena and Processes [G] - Physiological processes [G07]
Gender: Female, Male. Age: 18-64 years. Enrolment: 15.
Status: Authorised, recruitment pending. Decision date: 2025-01-28. Results received: No. Last updated: 2025-01-28.

Condition(s): Eosinophilic Esophagitis as a archetype of chronic inflammatory digestive disease

Source: https://euclinicaltrials.eu/ctis-public/view/2025-520751-83-00